EU clinical trial 2024-514241-10-00: KAPKEY - Phase II multicentric study of pembrolizumab in classic or endemic Kaposi’s sarcoma
Protocol code: P160601j
Sponsor: Assistance Publique Hopitaux De Paris (Hospital/Clinic/Other health care facility). Phase: Therapeutic exploratory (Phase II). Countries: France (ongoing, recruiting).
Therapeutic area(s): Diseases [C] - Neoplasms [C04]
Gender: Female, Male. Age: 18-64 years, 65+ years. Enrolment: 37.
Status: Ongoing, recruiting. Start date (EU): 2024-10-22. Decision date: 2024-10-22. Results received: No. Last updated: 2026-04-23.

Condition(s): Kaposi's sarcoma
Product: PEMBROLIZUMAB

Primary endpoint: the Best Overall Response Rate (BORR) defined by the occurrence of complete response or partial response following ACTG criteria recorded from the start of treatment until 6 months or the beginning of any other specific systemic therapy for KS if it occurs before 6 months., For Extension stage The primary endpoint of this stage will be the best overall response rate according to the ACTG criteria recorded from the start of treatment until 24 months or the beginning of any other specific systemic therapy for KS if it occurs before 6 months.

Source: https://euclinicaltrials.eu/ctis-public/view/2024-514241-10-00